EU clinical trial 2022-503132-14-00: A Phase 1b Study of JNJ-78278343, Targeting Human Kallikrein 2 (KLK2), in Combination with Other Agents for Metastatic Prostate Cancer
Protocol code: 78278343PCR1003
Sponsor: Janssen - Cilag International (Pharmaceutical company). Phase: Human Pharmacology (Phase I)- Other. Countries: Spain (ongoing, recruiting).
Therapeutic area(s): Diseases [C] - Neoplasms [C04]
Gender: Male. Age: 18-64 years, 65+ years. Enrolment: 18.
Status: Ongoing, recruiting. Start date (EU): 2025-06-30. Decision date: 2025-03-10. Results received: No. Last updated: 2026-06-05.

Condition(s): Metastatic Prostate Cancer

Source: https://euclinicaltrials.eu/ctis-public/view/2022-503132-14-00